EU clinical trial 2023-505995-31-00: A Phase 1/2, First-in-Human, Single and Multiple Ascending Dose Study to Investigate the Safety, Tolerability, Pharmacokinetics, Pharmacodynamics, and Efficacy of HMB-001 in Participants With Glanzmann Thrombasthenia
Protocol code: HMB-001-CL101
Sponsor: Hemab ApS (Pharmaceutical company). Phase: Phase I and Phase II (Integrated)- First administration to humans. Countries: Netherlands (ongoing, recruiting), Italy (ongoing, recruiting), Belgium (ongoing, recruiting), France (ongoing, recruiting).
Therapeutic area(s): Not possible to specify
Gender: Female, Male. Age: 18-64 years. Enrolment: 20.
Status: Ongoing, recruiting. Start date (EU): 2024-05-03. Decision date: 2024-02-19. Results received: No. Last updated: 2026-05-11.
Decision dates by country: NL: 2024-02-19, IT: 2024-02-19, FR: 2024-02-26, BE: 2024-05-17

Condition(s): Glanzmann Thrombasthenia
Product: HMB-001

Primary endpoint: 1. Part A • Safety as assessed by the incidence of treatment emergent adverse events (AEs) and changes in physical examinations, vital signs, clinical laboratory assessments, and electrocardiogram (ECG) parameters., 2. Part B and Part C • Safety as assessed by the incidence of treatment emergent AEs and changes in physical examinations, vital signs, clinical laboratory assessments, and ECG parameters., 3. Part B and Part C • Preliminary prophylactic effect of HMB-001 as assessed via: − Bleed frequency: annualized treated bleed rate (ATBR) and annualized bleed rate (ABR)
Endpoint(s): 1. Part A • Plasma concentrations of HMB-001 • PK parameters including, but not limited to: − Maximum observed plasma concentration (Cmax) − Area under the curve from time zero to last quantifiable concentration (AUClast) − Area under the curve from time zero to extrapolated infinite time (AUCinf) − Time to reach maximum observed plasma concentration (Tmax), 2. Part A • Anti-drug antibody (ADA) formation, 3. Part A • PD parameters including, but not limited to: − Maximum, mean increase in FVII from baseline − Maximum, mean decrease from baseline in prothrombin time (PT) − Maximum, mean decrease from baseline in activated partial thromboplastin time (aPTT)., 4. Part B and Part C • Plasma concentrations of HMB-001 • PK parameters including, but not limited to: − Cmax − AUClast − AUCinf − Tmax., 5. Part B and Part C • Preliminary prophylactic effect of HMB-001 as assessed by: - Subcategories of ABR, including, but not limited to: o Sponstaneous and impactful − Bleed Severity o Occurrence of severe bleeding events, 6. Part B and Part C • Preliminary prophylactic effect of HMB-001 as assessed by: − Requirement for Treatment o Volume of transfusion product use: platelets, fresh frozen plasma, cryoprecipitate o Volume of Factor Concentration use: rFVIIa o Volume of red blood cell (RBC) transfusion − Iron Status o Mean change in hemoglobin from baseline o Mean change in ferritin and total iron from baseline, 7. Part B and Part C • ADA formation., 8. Part B and Part C • Changes from baseline in Euro Quality of life 5- Dimensions 5-Level (EQ-5D-5L), Patient-Reported Outcomes Measurement Information System (PROMIS)-29, and Work Productivity and Activity Impairment (WPAI) scores.

Source: https://euclinicaltrials.eu/ctis-public/view/2023-505995-31-00